EU clinical trial 2025-522574-36-00: A Study to Learn How Different Forms of The Study Medicine Called Prazosin Are Taken up Into the Blood in Healthy Adults
Protocol code: A0281007
Sponsor: Pfizer Inc. (Pharmaceutical company). Phase: Human Pharmacology (Phase I)- Bioequivalence Study. Countries: Belgium (ended).
Therapeutic area(s): Diseases [C] - Cardiovascular Diseases [C14]
Gender: Female, Male. Age: 18-64 years, 65+ years. Enrolment: 72.
Status: Ended. Start date (EU): 2025-11-04. End date (EU): 2026-04-30. End date: 2026-05-01. Decision date: 2025-10-10. Results received: No. Last updated: 2025-10-10.

Condition(s): Primary and secondary hypertension, and heart failure

Source: https://euclinicaltrials.eu/ctis-public/view/2025-522574-36-00